EU clinical trial 2023-506609-21-00: Sleep and Temperature Disturbance as risk factors for Alzheimer's Disease in Down Syndrome: a Longitudinal Study.
Protocol code: IIBSP-DOW-2022-150
Sponsor: Fundacio Institut De Recerca De L Hospital De La Santa Creu I Sant Pau (Hospital/Clinic/Other health care facility). Phase: Therapeutic exploratory (Phase II). Countries: Spain (ongoing, recruiting).
Therapeutic area(s): Psychiatry and Psychology [F] - Mental Disorders [F03]
Gender: Female, Male. Age: 18-64 years. Enrolment: 60.
Status: Ongoing, recruiting. Start date (EU): 2024-04-09. Decision date: 2024-01-15. Results received: No. Last updated: 2025-04-22.

Condition(s): Down Syndrome., Alzheimer´s Disease.
Product: [18F]PI-2620

Primary endpoint: The primary endpoint derived from radiopharmaceutical administration of the radiopharmaceutical will be the Standardized uptake value ratio (SUVR) of the images generated with 18F-PI- 2620, which will be co-registered with the structural magnetic resonance magnetic resonance imaging (MRI) using SPM12 software. The cerebellum will be used as the reference region., Longitudinal changes in the assessment of neurofibrillary pathology through the Tau tracer (SUVR in Braak regions as defined by Berkeley regions of interest for PI-2620). by Berkeley regions of interest for PI-2620).
Endpoint(s): Correlation of SUVR with longitudinal changes in the assessment of neurofibrillary pathology through Tau tracer neurofibrillary pathology through the Tau tracer (SUVR in Braak regions as defined by Berkeley regions of interest for PI-2620). by Berkeley regions of interest for PI-2620)., Correlation of SUVR with clinical variables (CAMDEX-DS, CAMCOG) to be obtained from the neuropsychological evaluations., Correlation of SUVR with measures of brain atrophy (cortical thickness) as measured by FreeSurfer based on data derived from MRI acquisition., Correlation of SUVR with plasma biomarker measurements.

Source: https://euclinicaltrials.eu/ctis-public/view/2023-506609-21-00